EU clinical trial 2022-502382-25-00: A Phase IIb Randomised, Double-blind, Placebo-controlled, Multi-centre, Dose-ranging Study of AZD3427 in Participants with Heart Failure and Pulmonary Hypertension due to Left Heart Disease (WHO Group 2)
Protocol code: D8330C00003
Sponsor: AstraZeneca AB (Pharmaceutical company). Phase: Therapeutic exploratory (Phase II). Countries: Denmark (ended), Poland (ended), Czechia (ended), Netherlands (ended), Spain (ended), Germany (ended), Italy (ended), Austria (ended), Sweden (ended).
Therapeutic area(s): Diseases [C] - Cardiovascular Diseases [C14]
Gender: Female, Male. Age: 18-64 years, 65+ years. Enrolment: 176.
Status: Ended. Start date (EU): 2023-08-24. End date (EU): 2025-08-25. End date: 2025-08-26. Decision date: 2023-07-11. Results received: No. Last updated: 2025-10-02.
Decision dates by country: CZ: 2023-07-12, DE: 2023-07-12, AT: 2023-07-17, DK: 2023-07-11, NL: 2023-07-17, SE: 2023-11-06, ES: 2023-07-12, PL: 2023-07-17, IT: 2023-07-13

Condition(s): Heart Failure and Pulmonary Hypertension due to Left Heart Disease (WHO Group 2)
Product: Placebo for AZD3427 or AZD3427 Diluent, AZD3427

Primary endpoint: Change in PVR from baseline to Week 25 compared with placebo, as measured by RHC
Endpoint(s): Change from baseline to Week 25 in RHC parameters compared with placebo. Parameters include: • mPAP and PAWP. Change from baseline to Week 25 in echocardiographic parameters compared with placebo. Parameters include: • Cardiac output, SV, EF, LVGLS, PASP, RV/LV ratio, RVOT AT, TRV, TAPSE/PASP. • Systemic vascular resistance, Change in 6MWD and KCCQ TSS from baseline to Week 25 compared with placebo. Change in NYHA FC from baseline to Week 25 compared with placebo., Change in serum creatinine, NT-proBNP, cystatin C, and eGFR from baseline to Week 13 and Week 25 compared with placebo., AZD3427 serum PK concentrations., Presence of ADAs and evaluation of ADA titres.

Source: https://euclinicaltrials.eu/ctis-public/view/2022-502382-25-00